EU clinical trial 2023-504780-17-00: A Phase 1 Open-label, Parallel-Group, Single-Dose Study to Evaluate the Pharmacokinetics and Safety of Obeldesivir in Participants With Normal Renal Function and Renal Impairment
Protocol code: GS-US-611-6472
Sponsor: Gilead Sciences Inc. (Pharmaceutical company). Phase: Human Pharmacology (Phase I)- Other. Countries: Germany (ended).
Therapeutic area(s): Diseases [C] - Virus Diseases [C02]
Gender: Female, Male. Age: 18-64 years, 65+ years. Enrolment: 10.
Status: Ended. Start date (EU): 2024-03-19. End date (EU): 2024-06-14. End date: 2024-06-15. Decision date: 2024-01-15. Results received: Yes. Last updated: 2024-01-15.

Condition(s): Renal Impairment
Product: GS-5245 tablets 175 mg, GS-5245 tablets 350 mg

Primary endpoint: Plasma PK parameters Cmax, AUClast, and AUCinf of GS-441524 (ODV metabolite)
Endpoint(s): Incidence of AEs and laboratory abnormalities., Urine concentrations of GS-441524 (ODV metabolite) and its urine PK parameters (Ae, CLr, and %Fe).

Source: https://euclinicaltrials.eu/ctis-public/view/2023-504780-17-00